EU clinical trial 2023-507724-23-00: Phase 1b Study to Assess the Safety, Tolerability and Pharmacodynamics of PBFT02 in Adult Participants with Frontotemporal Dementia (FTD) and GRN or C9orf72 Mutations
Protocol code: PBFT02-001
Sponsor: Passage Bio Inc. (Pharmaceutical company). Phase: Phase I and Phase II (Integrated)- First administration to humans. Countries: Portugal (ended), Spain (ended).
Therapeutic area(s): Diseases [C] - Nervous System Diseases [C10]
Gender: Female, Male. Age: 18-64 years, 65+ years. Enrolment: 4.
Status: Ended. Start date (EU): 2024-02-01. End date (EU): 2026-05-07. End date: 2026-06-19. Decision date: 2023-10-11. Results received: No. Last updated: 2026-05-15.
Decision dates by country: PT: 2023-10-11, ES: 2025-06-04

Condition(s): FRONTOTEMPORAL DEMENTIA (FTD)

Source: https://euclinicaltrials.eu/ctis-public/view/2023-507724-23-00